EU clinical trial 2024-517668-51-01: Clinical trial on the effectiveness and safety of botulinum toxin type A (incobotulinumtoxin) in doses adapted to the individual needs of patients with severe spasticity
Protocol code: ESPSEVMOLIN2022
Sponsor: Dra. Nuria Gutierrez Dubón (Health care). Phase: Therapeutic use (Phase IV). Countries: Spain (ongoing, recruiting).
Therapeutic area(s): Diseases [C] - Nervous System Diseases [C10]
Gender: Female, Male. Age: 18-64 years, 65+ years. Enrolment: 30.
Status: Ongoing, recruiting. Start date (EU): 2023-05-03. Decision date: 2024-10-02. Results received: No. Last updated: 2024-10-02.

Condition(s): brain damage oriented spasticity
Product: XEOMIN 50 unidades polvo para solución inyectable, BOTULINUM TOXIN TYPE A

Primary endpoint: Asworth scale at 6 weeks of treatment
Endpoint(s): Pain: Variation on the VAS scale (0-10) at 6 and 12 weeks of treatment, Effect on the Asworth scale at 12 weeks from drug infiltration, Barthel scale at 6 and 12 weeks after injection, Satisfaction with treatment, Assess the safety and tolerability of the treatment

Source: https://euclinicaltrials.eu/ctis-public/view/2024-517668-51-01